EU clinical trial 2023-504303-86-00: A Phase III, Multicenter, Randomized, Open-Label Study of Atezolizumab (Anti-PD-L1 Antibody) Plus Bevacizumab Versus Active Surveillance as Adjuvant Therapy in Patients with Hepatocellular Carcinoma at High Risk of Recurrence After Surgical Resection or Ablation
Protocol code: WO41535
Sponsor: F. Hoffmann-La Roche AG (Pharmaceutical company). Phase: Therapeutic confirmatory (Phase III). Countries: Czechia (ongoing, recruitment ended), Germany (ended), Italy (ongoing, recruitment ended), Spain (ended), France (ended), Belgium (ended), Austria (ended), Netherlands (ongoing, recruitment ended), Poland (ongoing, recruitment ended).
Therapeutic area(s): Diseases [C] - Neoplasms [C04]
Gender: Female, Male. Age: 18-64 years, 65+ years. Enrolment: 72.
Start date (EU): 2019-11-21. Decision date: 2024-06-12. Results received: No. Last updated: 2026-04-08.
Decision dates by country: NL: 2024-06-18, FR: 2024-06-13, IT: 2024-06-17, ES: 2024-06-12, CZ: 2024-06-13, AT: 2024-07-08, DE: 2024-06-17, BE: 2024-06-13, PL: 2024-07-01

Condition(s): High-risk hepatocellular carcinoma (HCC)
Product: Tecentriq 1 200 mg concentrate for solution for infusion, Avastin 25 mg/ml concentrate for solution for infusion.

Primary endpoint: 1. Independent Review Facility (IRF)-assessed recurrence-free survival (RFS)
Endpoint(s): 1. Overall Survival (OS) rate at 24 months and 36 months, 2. OS, 3. RFS as determined by the investigator, 4. Time to Recurrence (TTR), 5. Time to extrahepatic spread (EHS) or macrovascular invasion, 6. RFS after randomization as determined by the investigator and by an IRF, among patients in the PD-L1-high subgroup, 7. Incidence and severity of adverse events, with severity determined according to NCI CTCAE v5.0, 8. Change from baseline in targeted vital signs, 9. Change from baseline in targeted clinical laboratory test results, 10. Serum concentration of atezolizumab at specified timepoints, 11. Prevalence of anti-drug antibody (ADAs) to atezolizumab at baseline and incidence of ADAs to atezolizumab during the study, 12. IRF-assessed RFS and investigator-assessed RFS rate at 24 and 36 months after randomization

Source: https://euclinicaltrials.eu/ctis-public/view/2023-504303-86-00